EU clinical trial 2025-520744-14-00: CReep and maintenance flUid Salt ADministration rEduction in cRitically ill adultS - (CRUSADERS)
Sponsor: Universitair Ziekenhuis Antwerpen (Hospital/Clinic/Other health care facility). Phase: Therapeutic use (Phase IV). Countries: Belgium (ongoing, recruiting).
Therapeutic area(s): Not possible to specify
Gender: Female, Male. Age: 18-64 years, 65+ years. Enrolment: 640.
Status: Ongoing, recruiting. Start date (EU): 2025-10-01. Decision date: 2025-06-13. Results received: No. Last updated: 2025-06-13.

Condition(s): Critically ill patients
Product: Natriumchloride 0,9 % w/v, Viaflo, oplossing voor infusie, NaCl 0,3% w/v + Glucose 3,3% w/v Viaflo, oplossing voor intraveneuze infusie, Glucose 5 % w/v, Viaflo, oplossing voor infusie, Plasmalyte A Viaflo, oplossing voor infusie.

Primary endpoint: The primary endpoint of the CRUSADERS study is Days alive and without life support (DAWOLS) at 90 days after ICU admission.
Endpoint(s): Occurrence of moderate and severe hyponatremia, Occurrence of moderate and severe hypernatremia, Occurrence of moderate and severe hyperchloremia, Fluid retention and diuretic use, Occurrence of hyperglycemia and hypoglycemia, Acute kidney injury, Mechanical ventilation, Mortality and length of stay, Daily and cumulative sodium, chloride and glucose administration: daily and cumulative sodium, chloride and glucose administration from all sources except for non-study fluid creep and oral intake. For blood products, estimated values of sodium and chloride content are used., Fluid balance: Daily and cumulative fluid balance on ICU days, excluding (calculations of) insensible losses. From the moment RRT or IV loop diuretics are started, fluid balance data are analyzed separately from the patients without those interventions. Fluid balance assessments are discontinued from the ICU day when the urinary catheter is removed or bladder irrigation is initiated.

Source: https://euclinicaltrials.eu/ctis-public/view/2025-520744-14-00